EU clinical trial 2023-504492-24-00: Physiologically based pharmacokinetic modelling of oral and intranasal formulations of zolmitriptan in healthy volunteers
Protocol code: IMIMFCTL/ZOL_1
Sponsor: Parc De Salut Mar (Hospital/Clinic/Other health care facility). Phase: Human Pharmacology (Phase I)- Other. Countries: Spain (ended).
Therapeutic area(s): Not possible to specify
Gender: Female, Male. Age: 18-64 years. Enrolment: 8.
Status: Ended. Start date (EU): 2023-07-12. End date (EU): 2023-09-26. Decision date: 2023-07-03. Results received: No. Last updated: 2023-07-03.

Condition(s): healthy

Source: https://euclinicaltrials.eu/ctis-public/view/2023-504492-24-00